EU clinical trial 2022-500881-80-00: A Pivotal Phase 3 Randomized, Placebo-controlled Clinical Study to Evaluate the Efficacy and Safety of the sGC Stimulator Vericiguat/MK-1242 in Adults With Chronic Heart Failure With Reduced Ejection Fraction
Protocol code: MK-1242-035
Sponsor: Merck Sharp & Dohme LLC (Pharmaceutical company). Phase: Therapeutic confirmatory (Phase III). Countries: Sweden (ended), Spain (ended), Hungary (ended), Italy (ended), Denmark (ended), France (ended), Ireland (ended), Austria (ended), Germany (ended), Czechia (ended), Poland (ended), Greece (ended).
Therapeutic area(s): Diseases [C] - Cardiovascular Diseases [C14]
Gender: Female, Male. Age: 18-64 years, 65+ years. Enrolment: 2214.
Status: Ended. Start date (EU): 2021-10-29. End date (EU): 2025-01-28. End date: 2025-02-06. Decision date: 2023-04-26. Results received: Yes. Last updated: 2025-02-24.
Decision dates by country: IT: 2023-05-02, SE: 2023-04-27, IE: 2023-04-26, HU: 2023-04-27, PL: 2023-05-02, DK: 2023-04-26, AT: 2023-05-02, ES: 2023-04-28, CZ: 2023-05-02, FR: 2023-04-26, GR: 2023-05-08, DE: 2023-05-12

Condition(s): Chronic Heart Failure With Reduced Ejection Fraction
Product: Placebo to MK-1242 tablet 2.5 and 5 mg, Placebo to MK-1242 tablet 10 mg, Vericiguat, Vericiguat, Vericiguat

Primary endpoint: Time to First Occurrence of Composite Endpoint of Cardiovascular (CV) Death or Heart Failure (HF) Hospitalization
Endpoint(s): Time to First Occurrence of CV Death, Time to First Occurrence of HF Hospitalization, Time to Total HF Hospitalizations (Including First and Recurrent Events), Time to First Occurrence of Composite Endpoint of All-Cause Mortality or HF Hospitalization, Time to All-Cause Mortality, Percentage of Participants who Experienced One or More Selected Nonserious Adverse Events (NSAE), Percentage of Participants Who Experienced One or More Serious Adverse Events (SAE), Percentage of Participants Who Experienced One or More Events of Clinical Interest (ECI)

Source: https://euclinicaltrials.eu/ctis-public/view/2022-500881-80-00